EU clinical trial 2024-515715-22-00: A Phase 3, randomized, double-blind, placebo-controlled, multicenter, clinical trial with extension period to evaluate the efficacy and safety of Xeomin® injections for the prevention of episodic migraine (MINT-E)
Protocol code: M602011085
Sponsor: Merz Therapeutics GmbH (Pharmaceutical company). Phase: Therapeutic confirmatory (Phase III). Countries: Italy (ongoing, recruiting), Austria (ongoing, recruiting), Poland (ongoing, recruiting), Germany (ongoing, recruiting), France (ongoing, recruiting), Spain (ongoing, recruiting), Slovakia (ongoing, recruiting), Denmark (ongoing, recruiting), Czechia (ongoing, recruiting).
Therapeutic area(s): Diseases [C] - Nervous System Diseases [C10]
Gender: Female, Male. Age: 18-64 years, 65+ years. Enrolment: 657.
Status: Ongoing, recruiting. Start date (EU): 2025-10-06. Decision date: 2025-09-01. Results received: No. Last updated: 2026-07-31.
Decision dates by country: IT: 2025-09-01, DK: 2025-10-22, SK: 2025-09-01, ES: 2025-10-17, FR: 2025-10-28, AT: 2025-09-05, CZ: 2025-11-19, DE: 2025-09-03, PL: 2025-09-08

Condition(s): Episodic migraine
Product: Placebo to Clostridium Botulinum neurotoxin type A (150 kD), CLOSTRIDIUM BOTULINUM NEUROTOXIN TYPE A (150KD), FREE OF COMPLEXING PROTEINS

Primary endpoint: Change in monthly migraine days from baseline (28 days before baseline visit) to Month 6 (weeks 21 to 24 after first injection) – Dose A.
Endpoint(s): Change in monthly migraine days from baseline (28 days before baseline visit) to Month 6 (weeks 21 to 24 after first injection) – Dose B., Change in monthly headache days from baseline (28 days before baseline visit) to Month 6 (weeks 21 to 24 after first injection) – Dose A., Change in monthly headache days from baseline (28 days before baseline visit) to Month 6 (weeks 21 to 24 after first injection) – Dose B., Change in monthly acute migraine medication days from baseline (28 days before baseline visit) to Month 6 (weeks 21 to 24 after first injection) – Dose A., Change in monthly acute migraine medication days from baseline (28 days before baseline visit) to Month 6 (weeks 21 to 24 after first injection) – Dose B., Change in frequency of migraine days from baseline (baseline monthly migraine days divided by 2) to two-week end-of-cycle periods (weeks 11 and 12 of Cycle 1 to 4)., Percentage of participants who reported at least a 50% reduction in mean monthly migraine days from baseline (28 days before baseline visit) to Month 6 (weeks 21 to 24 after first injection)., Incidence of treatment‑emergent adverse events (TEAEs) related to treatment as assessed by the investigator in the placebo-controlled period (PCP).

Source: https://euclinicaltrials.eu/ctis-public/view/2024-515715-22-00